EU clinical trial 2022-501431-16-00: A Single-arm, Phase II Study to Evaluate the Efficacy and Safety of Linperlisib (YY-20394) Monotherapy in Patients with Relapsed or Refractory Peripheral T/NK Cell or Cutaneous T Cell Lymphoma
Protocol code: YY-20394-012
Sponsor: Shanghai Yingli Pharmaceutical Co. Ltd. (Pharmaceutical company). Phase: Therapeutic exploratory (Phase II). Countries: Italy (ended).
Therapeutic area(s): Diseases [C] - Neoplasms [C04]
Gender: Female, Male. Age: 18-64 years, 65+ years. Enrolment: 16.
Status: Ended. Start date (EU): 2023-01-17. End date (EU): 2024-06-18. End date: 2024-07-17. Decision date: 2022-11-25. Results received: No. Last updated: 2024-04-11.

Condition(s): Relapsed or Refractory Peripheral T/NK Cell or Cutaneous T Cell Lymphoma
Product: Linperlisib

Primary endpoint: Overall response rate (ORR = CR + PR) for PTCL, from start of treatment to first documented response, measured by Lugano 2014 Response Criteria for NHL (Cheson 2014) Overall response rate (ORR = CR + PR) for CTCL, from start of treatment to first documented response, based on Olsen Global Response Score (Olsen 2011)
Endpoint(s): DOR, defined as time from first documentation of a response (PR or CR) to the first documented disease progression or death due to any cause, whichever occurs first, for those patients with a PR or CR., PFS, defined as the time from start of treatment to first documented disease progression or death due to any cause, whichever occurs first. Overall survival (OS) Time to response (TTR), Incidence and severity of Adverse events (AEs) using the National Cancer Institute Common Terminology Criteria for Adverse Events (NCI-CTCAE) Version 5.0 Discontinuation of study treatment due to an AE, PK parameters include: AUClast, AUCinf, Cmin, Cmax, T1/2, and Tmax., Exploratory: to investigate correlations between protein biomarkers, immune cells, and gene mutations in PTCL or CTCL tumors and blood with response and survival

Source: https://euclinicaltrials.eu/ctis-public/view/2022-501431-16-00